EU clinical trial 2024-518020-68-00: DMT in healthy subjects
Protocol code: CHDR2227
Sponsor: Algernon Pharmaceuticals Inc. (Pharmaceutical company). Phase: Human Pharmacology (Phase I)- Other. Countries: Netherlands (ended).
Therapeutic area(s): Diseases [C] - Nervous System Diseases [C10]
Gender: Female, Male. Age: 18-64 years. Enrolment: 60.
Status: Ended. Start date (EU): 2022-11-15. End date (EU): 2026-05-26. Decision date: 2024-11-21. Results received: No. Last updated: 2024-11-21.

Condition(s): Stroke

Source: https://euclinicaltrials.eu/ctis-public/view/2024-518020-68-00